EU clinical trial 2023-508729-28-00: A participant - and investigator-blinded, randomized, placebo-controlled, multicenter, platform study to investigate efficacy, safety, and tolerability of various single treatments in patients with idiopathic pulmonary fibrosis
Protocol code: CADPT09A12201
Sponsor: Novartis Pharma AG (Pharmaceutical company). Phase: Therapeutic exploratory (Phase II). Countries: Germany (ended), Czechia (ended), Netherlands (ended), Poland (ended).
Therapeutic area(s): Diseases [C] - Respiratory Tract Diseases [C08]
Gender: Female, Male. Age: 18-64 years, 65+ years. Enrolment: 36.
Status: Ended. Start date (EU): 2023-04-25. End date (EU): 2024-09-26. End date: 2024-09-27. Decision date: 2024-03-04. Results received: Yes. Last updated: 2024-03-18.
Decision dates by country: CZ: 2024-03-04, DE: 2024-03-06, NL: 2024-03-04, PL: 2024-03-18

Condition(s): Idiopathic pulmonary fibrosis
Product: LTP001, Placebo to LTP001 1mg and 5mg hard gelatin capsules, LTP001

Primary endpoint: Change from baseline to end of treatment epoch (26 weeks of treatment) in Forced Vital Capacity (FVC) expressed in percent predicted
Endpoint(s): Change from baseline to end of treatment epoch (26 weeks of treatment) in Forced Vital Capacity (FVC) expressed in mL, • Time to progression as defined by a composite endpoint including any of the following events: • Absolute reduction from baseline of ≥10% predicted in FVC • Nonelective hospitalization for respiratory events • Lung Transplant • Death, Number of participants with absolute decline of ≥10% predicted in FVC, Change from baseline to the end of treatment epoch (26 weeks of treatment) in DLCO absolute and percent predicted, Change from baseline to the end of treatment epoch (26 weeks of treatment) in 6-minute walk distance, Change from baseline to the end of treatment epoch (26 weeks of treatment) in scores from the L-IPF (Impacts and Symptoms Modules), K-BILD, Leicester cough, and R-Scale for PF questionnaires, Adverse Events, physical examinations, labs, ECGs, vital signs

Source: https://euclinicaltrials.eu/ctis-public/view/2023-508729-28-00